EU clinical trial 2023-504038-23-00: A Phase Ib/II, Open-Label, Multicenter, Randomized Umbrella Study Evaluating the Efficacy and Safety of Multiple Immunotherapy-Based Treatment Combinations in Patients with Metastatic Non-Small Cell Lung Cancer (Morpheus-Lung)
Protocol code: BO39610
Sponsor: F. Hoffmann-La Roche AG (Pharmaceutical company). Phase: Phase I and Phase II (Integrated)- Other. Countries: France (ended), Spain (ended).
Therapeutic area(s): Diseases [C] - Neoplasms [C04]
Gender: Female, Male. Age: 18-64 years, 65+ years. Enrolment: 149.
Status: Ended. Start date (EU): 2018-05-10. End date (EU): 2025-04-02. End date: 2025-11-26. Decision date: 2024-06-27. Results received: Yes. Last updated: 2025-02-14.
Decision dates by country: FR: 2024-07-02, ES: 2024-06-27

Condition(s): Metastatic non-small cell lung cancer (NSCLC)
Product: Avastin 25 mg/ml concentrate for solution for infusion., Tecentriq, Docetaxel Accord 80 mg/4 ml concentrate for solution for infusion, Camonsertib, Trajenta 5 mg film-coated tablets

Primary endpoint: Stage 1 1. Objective response rate (ORR)
Endpoint(s): Stage 1 1. PFS, Stage 1 2. PFS at specific time points, Stage 1 3. OS, Stage 1 4. OS at specific time points, Stage 1 5. DOR, Stage 1 6. DCR, Stage 1 and 2 7. Incidence, nature, and severity of adverse events and laboratory abnormalities, with severity determined according to National Cancer Institute Common Terminology Criteria for Adverse Events, Version 4.0, Stage 1 and 2 8. Change from baseline in vital signs, electrocardiogram parameters and targeted clinical laboratory test results

Source: https://euclinicaltrials.eu/ctis-public/view/2023-504038-23-00